EU clinical trial 2023-506588-32-00: A Phase 3 Randomized Study Comparing JNJ-68284528, a Chimeric Antigen Receptor T cell (CAR-T) Therapy Directed Against BCMA, versus Pomalidomide, Bortezomib and Dexamethasone (PVd) or Daratumumab, Pomalidomide and Dexamethasone (DPd) in Subjects with Relapsed and Lenalidomide-Refractory Multiple Myeloma CARTITUDE-4
Protocol code: 68284528MMY3002
Sponsor: Janssen - Cilag International (Pharmaceutical company). Phase: Therapeutic confirmatory (Phase III). Countries: France (ongoing, recruitment ended), Belgium (ongoing, recruitment ended), Greece (ended), Italy (ongoing, recruitment ended), Spain (ongoing, recruitment ended), Poland (ongoing, recruitment ended), Netherlands (ongoing, recruitment ended), Denmark (ongoing, recruitment ended), Sweden (ongoing, recruitment ended), Germany (ongoing, recruitment ended).
Therapeutic area(s): Diseases [C] - Neoplasms [C04]
Gender: Female, Male. Age: 18-64 years, 65+ years. Enrolment: 233.
Start date (EU): 2020-06-12. Decision date: 2024-03-21. Results received: No. Last updated: 2026-04-08.
Decision dates by country: GR: 2024-05-02, NL: 2024-03-21, IT: 2024-03-22, SE: 2024-03-26, BE: 2024-04-04, FR: 2024-03-27, DK: 2024-03-21, DE: 2024-03-21, ES: 2024-03-26, PL: 2024-04-15

Condition(s): Relapsed and Lenalidomide-Refractory Multiple Myeloma
Product: Pomalidomide, Imnovid 3 mg hard capsules, Imnovid 1 mg hard capsules, Imnovid 2 mg hard capsules, Imnovid 4 mg hard capsules, Pomalidomide, Pomalidomide, DARZALEX 1800 mg solution for injection, Imnovid 3 mg hard capsules, BORTEZOMIB, Imnovid 2 mg hard capsules, FLUDARABINE, CARVYKTI 3.2 × 10^6 – 1.0 × 10^8 cells dispersion for infusion, Pomalidomide, Imnovid 4 mg hard capsules, Dexamethasone Tablets BP 2.0mg, Fortecortin® 2 mg Tabletten, Imnovid 1 mg hard capsules, CYCLOPHOSPHAMIDE, Dexamethason 4 mg JENAPHARM®

Primary endpoint: Progression-free survival (PFS)

Source: https://euclinicaltrials.eu/ctis-public/view/2023-506588-32-00